EU clinical trial 2024-515419-24-00: Study of a novel combination of immunovirologic and genetic parameters in early-treated HIV-1 patients undergone to antiretroviral therapy interruption (ATI) aimed at defining an algorithm predictive of post-treatment control (PCT)
Sponsor: Ospedale San Raffaele S.r.l. (Hospital/Clinic/Other health care facility). Phase: Therapeutic use (Phase IV). Countries: Italy (ongoing, recruiting).
Therapeutic area(s): Diseases [C] - Immune System Diseases [C20]
Gender: Female, Male. Age: 18-64 years. Enrolment: 100.
Status: Ongoing, recruiting. Start date (EU): 2022-04-27. Decision date: 2024-07-15. Results received: No. Last updated: 2024-07-15.

Condition(s): HIV-1 positive subjects treated with effective antiretroviral therapy during the acute phase of HIV-1 infection
Product: DOLUTEGRAVIR AND RILPIVIRINE

Primary endpoint: Step 1: To complete the immune-virologic and immune-genetic profiling of volunteers enrolled in the study and perform all the statistical analysis within the time frame proposed (21 months) before the beginning of the MAP cohort recruitment, Step 2: Proportion of participants who controlled viremia counts (<50%) and maintained a stable CD4 T-cell count = 350 cells/μl for all the follow-up (6 months) (no CD4 significant drop)

Source: https://euclinicaltrials.eu/ctis-public/view/2024-515419-24-00